EU clinical trial 2024-515267-59-00: Venetoclax plus azacitidine versus standard intensive chemotherapy for patients with newly diagnosed acute myeloid leukemia (AML) and NPM1 mutations eligible for intensive treatment (VINCENT)
Protocol code: TUD-VINC01-080
Sponsor: Technische Universitaet Dresden (Educational Institution). Phase: Therapeutic exploratory (Phase II). Countries: Germany (ongoing, recruiting).
Therapeutic area(s): Diseases [C] - Neoplasms [C04]; Diseases [C] - Hemic and Lymphatic Diseases [C15]
Gender: Female, Male. Age: 18-64 years, 65+ years. Enrolment: 146.
Status: Ongoing, recruiting. Start date (EU): 2024-04-07. Decision date: 2024-10-23. Results received: No. Last updated: 2026-04-22.
Decision dates by country: DE: 2025-01-27

Condition(s): Acute myeloid leukemia
Product: MITOXANTRONE, Venetoclax, Venetoclax, AZACITIDINE, Venetoclax, CYTARABINE, GEMTUZUMAB OZOGAMICIN, DAUNORUBICIN HYDROCHLORIDE, MITOXANTRONE

Primary endpoint: Modified Event-free survival (mEFS), Event is defined as: 1. Failure to achieve a CR/CRi/CRh after maximum of two induction cycles in the control arm (SOC) or three induction cycles in the investigational arm (VEN+AZA), i.e. primary induction failure, Event is defined as: 2. Hematologic relapse after previous CR/CRi/CRh, Event is defined as: 3. Molecular failure, defined as either: 3.1 Molecular progression, defined as confirmed ≥ 1 log10 increase of NPM1 MRD level in any two samples in a patient without prior MRD negativity or 3.2 Molecular relapse after previous MRD negativity, defined as confirmed ≥ 1 log10 between two consecutive positive samples in a patient who was previously tested as MRD negative, Event is defined as: 4. Death
Endpoint(s): Cumulative occurrence of grade 3 and 4 adverse events (tolerability), Rate of morphologic CR and CR/CRi/CRh with MRD negativity, MRD as detected by MFC and MRD kinetics in NPM1 real-time PCR, Rate of molecular response and molecular persistence, Relapse-free survival and overall survival, Early mortality (14 d, 30 d, 60 d from start of induction), Change in Health-related quality of life (QoL), Cumulative health-care resource use at 12 and 24 months

Source: https://euclinicaltrials.eu/ctis-public/view/2024-515267-59-00